EU clinical trial 2024-511627-34-00: Daratumumab in adults with Very High-Risk T-Lineage Acute Lymphoblastic Leukemia (ALL) Treated According to the ALL National Treatment Program (DARATALL-VHR)- GIMEMA ALL3024
Protocol code: ALL3024
Sponsor: Fondazione Gimema Franco Mandelli Onlus (Patient organisation/association). Phase: Therapeutic exploratory (Phase II). Countries: Italy (ongoing, recruitment ended).
Therapeutic area(s): Diseases [C] - Hemic and Lymphatic Diseases [C15]
Gender: Female, Male. Age: 18-64 years, 65+ years. Enrolment: 31.
Status: Ongoing, recruitment ended. Start date (EU): 2024-10-17. Decision date: 2024-07-26. Results received: No. Last updated: 2025-12-23.

Condition(s): Very High-Risk T-Lineage Acute Lymphoblastic Leukemia (ALL)
Product: APREPITANT, IDARUBICIN HYDROCHLORIDE, LEVOCARNITINE, CYCLOPHOSPHAMIDE, GRANISETRON, SALBUTAMOL, GANCICLOVIR, AMPHOTERICIN B, ALLOPURINOL, DARZALEX 1800 mg solution for injection, HUMAN FIBRINOGEN, CYTARABINE, DEXAMETHASONE SODIUM PHOSPHATE, VINCRISTINE SULFATE, PARACETAMOL, MONTELUKAST, FILGRASTIM, CYTARABINE, LEVOFLOXACIN, RASBURICASE, METHOTREXATE, HYDROCORTISONE, FOSCARNET, METHYLPREDNISOLONE SODIUM SUCCINATE, LENOGRASTIM, PEGASPARGASE, DEXAMETHASONE SODIUM PHOSPHATE, MICAFUNGIN, ACICLOVIR, CHLORPHENAMINE, CIPROFLOXACIN, DIPHENHYDRAMINE, FUROSEMIDE, CO-TRIMOXAZOLE, MERCAPTOPURINE, FOLINIC ACID, PREDNISONE, METHOTREXATE, ONDANSETRON

Primary endpoint: The primary endpoint of this study is to evaluate clinical response - in terms of MRD negativity (<10^-4) after induction (TP1) - in patients with very high-risk T-ALL treated with a daratumumab plus chemotherapy approach.
Endpoint(s): The rate of MRD negativity at TP2, TP3, TP4 and before allo-SCT, The rate of allo-SCT allocation, DFS at 12 months, EFS at 18 months, CIR estimation from CR achievement at 18 months, OS at 18 months, Treatment-related mortality (TRM), Rate of Adverse Events (AEs) and Serious AEs

Source: https://euclinicaltrials.eu/ctis-public/view/2024-511627-34-00